EU clinical trial 2024-516646-19-00: COLchicine and non-enteric coated aspirin in the Cardiovascular Outcomes Trial of patients with Type 2 Diabetes (COLCOT-T2D)
Protocol code: MHICC-2021-001
Sponsor: Montreal Heart Institute (Hospital/Clinic/Other health care facility). Phase: Therapeutic confirmatory (Phase III). Countries: Finland (ongoing, recruiting), Portugal (ongoing, recruiting), Greece (authorised, recruiting), Denmark (ongoing, recruiting), Italy (ongoing, recruiting), France (ongoing, recruiting).
Therapeutic area(s): Diseases [C] - Cardiovascular Diseases [C14]
Gender: Female, Male. Age: 18-64 years, 65+ years. Enrolment: 4350.
Start date (EU): 2025-08-15. Decision date: 2025-03-17. Results received: No. Last updated: 2026-04-30.
Decision dates by country: GR: 2025-03-19, PT: 2025-03-17, FR: 2025-05-09, IT: 2025-03-18, FI: 2025-03-18, DK: 2025-03-19

Condition(s): Type 2 diabetic patients with no prior cardiovascular (CV) events
Product: Placebo tablet matching acetylsalicylic acid, MIGOUTINE 0,5 mg, comprimé pelliculé, ACETYLSALICYLIC ACID, Placebo tablet matching migoutine 0,5 mg, comprimé pelliculé

Primary endpoint: The primary endpoint will be the time from randomization to the first event of the composite of cardiovascular death, resuscitated cardiac arrest, myocardial infarction (non-fatal), stroke (non-fatal), or urgent hospitalization for angina requiring coronary revascularization.
Endpoint(s): Times from randomization to each component of the primary endpoint; and to the first event of the composite of cardiovascular death, resuscitated cardiac arrest, myocardial infarction (non-fatal) or stroke (non-fatal), Total burden of first and subsequent primary endpoint events, Change from randomization in MoCA score at yearly follow-ups (excluding the first-year visit) until the end-of-study visit., Number and proportion of patients experiencing serious adverse events., For exploratory and safety end points please refer to the study protocol.

Source: https://euclinicaltrials.eu/ctis-public/view/2024-516646-19-00